EU clinical trial 2023-505692-72-00: Randomised, crossover bioequivalence clinical trial of hydrochlorothiazide 25 mg tablets, after a single oral dose administration to healthy volunteers under fasting conditions.
Protocol code: N-HID-23-279
Sponsor: Laboratorios Normon S.A. (Pharmaceutical company). Phase: Human Pharmacology (Phase I)- Bioequivalence Study. Countries: Spain (ended).
Therapeutic area(s): Not possible to specify
Gender: Female, Male. Age: 18-64 years. Enrolment: 30.
Status: Ended. Start date (EU): 2023-07-18. End date (EU): 2023-08-10. Decision date: 2023-07-14. Results received: Yes. Last updated: 2023-07-14.

Condition(s): Healthy volunteers
Product: Esidrex 25 mg comprimidos, Hidroclorotiazida Normon 25 mg comprimidos

Primary endpoint: AUC0-t, Cmax
Endpoint(s): AUC0-∞, Tmax, Residual area

Source: https://euclinicaltrials.eu/ctis-public/view/2023-505692-72-00